EU clinical trial 2025-521395-63-00: A clinical study of MK-1289 in healthy adult men (MK-1289-001)
Protocol code: MK-1289-001
Sponsor: Merck Sharp & Dohme LLC (Pharmaceutical company). Phase: Human Pharmacology (Phase I)- First administration to humans. Countries: Belgium (ended).
Therapeutic area(s): Diseases [C] - Virus Diseases [C02]
Gender: Male. Age: 18-64 years. Enrolment: 28.
Status: Ended. Start date (EU): 2025-06-04. End date (EU): 2025-09-26. End date: 2025-09-27. Decision date: 2025-06-02. Results received: No. Last updated: 2025-09-02.

Condition(s): COVID-19 Infection

Source: https://euclinicaltrials.eu/ctis-public/view/2025-521395-63-00